EU clinical trial 2024-510970-26-00: Olaparib and durvalumab (MEDI4736) in patients with metastatic pancreatic cancer and DNA Damage Repair genes alterations
Protocol code: TTD-20-04
Sponsor: Asociacion Grupo Tratamiento De Tumores Digestivos (Patient organisation/association). Phase: Therapeutic exploratory (Phase II). Countries: Spain (ongoing, recruitment ended).
Therapeutic area(s): Diseases [C] - Neoplasms [C04]
Gender: Female, Male. Age: 18-64 years, 65+ years. Enrolment: 40.
Status: Ongoing, recruitment ended. Start date (EU): 2022-11-28. Decision date: 2024-10-10. Results received: No. Last updated: 2026-05-13.

Condition(s): Metastatic pancreatic cancer
Product: DURVALUMAB, OLAPARIB

Primary endpoint: Overall Response Rate (ORR) defined as the percentage of patients with an investigator-assessed complete (CR) or partial response (PR) according to Response Evaluation Criteria in Solid tumours (RECIST) v1.1.
Endpoint(s): PFS defined as the time from initial date of study treatment to the date of objective disease progression according to RECIST 1.1 criteria or death (due to any cause), whichever occurs first., OS defined as the time from the initial date of the study treatment to the date of death (due to any cause), with patients alive or lost to follow-up at the analysis data cut-off date censored at their last contact date., DoR defined as time from first objective response to disease progression per RECIST 1.1 criteria or death (due to any cause). For patients with response who have not progressed or died at last observation, duration of response will be censored at their last evaluable disease assessment date., DCR defined as the percentage of patients who achieve complete response, partial response or stable disease., Assessment of AEs graded by NCI CTCAE v5.0, vital signs and evaluation of laboratory parameters.

Source: https://euclinicaltrials.eu/ctis-public/view/2024-510970-26-00